EU clinical trial 2023-504695-23-00: A Single Ascending Dose Clinical Study to Evaluate the Safety, Tolerability, and Pharmacokinetics of MK-1403 in Healthy Male Participants
Protocol code: MK-1403-001
Sponsor: Merck Sharp & Dohme LLC (Pharmaceutical company). Phase: Human Pharmacology (Phase I)- First administration to humans. Countries: Belgium (ended).
Therapeutic area(s): Diseases [C] - Cardiovascular Diseases [C14]
Gender: Male. Age: 18-64 years. Enrolment: 24.
Status: Ended. Start date (EU): 2023-06-15. End date (EU): 2023-10-06. End date: 2023-10-07. Decision date: 2023-06-14. Results received: Yes. Last updated: 2023-06-14.

Condition(s): Atherosclerosis
Product: Microcrystalline cellulose, Sodium Caprate, MK-1403 F1, Microcrystalline cellulose, Lactose monohydrate, Magnesium Stearate (non-bovine), MK-1403 F2, MK-1403 F1

Primary endpoint: Number of Participants Who Experience At least One Adverse Event (AE), Number of Participants Who Discontinue Study Treatment Due to an AE
Endpoint(s): Area Under the Curve from Time 0 to Infinity (AUC0-inf) of MK-1403, Area Under the Curve from Time 0 to 24 hours (AUC0-24) of MK-1403, Maximum Plasma Concentration (Cmax) of MK-1403, Plasma Concentration at 24 hours (C24) of MK-1403, Time to Maximum Plasma Concentration (Tmax) of MK-1403, Apparent Plasma Terminal Half-life (t1/2) of MK-1403, Area Under the Curve from Time 0 to Time of the Last Quantifiable Concentration (AUC0-t) of MK-1403

Source: https://euclinicaltrials.eu/ctis-public/view/2023-504695-23-00